EU clinical trial 2024-513856-14-00: NIRAPK : Study of the relationships between pharmacokinetic properties (PK) and hematological toxicity of niraparib in ovarian cancer
Protocol code: 69HCL20_0989
Sponsor: Hospices Civils De Lyon (Hospital/Clinic/Other health care facility). Phase: Therapeutic use (Phase IV). Countries: France (ended).
Therapeutic area(s): Diseases [C] - Female Urogenital Diseases and Pregnancy Complications [C13]
Gender: Female. Age: 18-64 years, 65+ years. Enrolment: 42.
Status: Ended. Start date (EU): 2021-05-05. End date (EU): 2025-04-17. Decision date: 2024-07-10. Results received: No. Last updated: 2024-07-10.

Condition(s): Patients with high-grade serous epithelial ovarian, tubal or primary peritoneal cancers
Product: Zejula 100 mg hard capsules

Primary endpoint: Identification of clinical/biological/pharmacokinetic/therapeutic factors leading to hematological and/or renal toxicology(s).
Endpoint(s): Relation of the average pharmacokinetic parameters observed in patients according to the clinical/biological/therapeutic and dietary parameters studied., Relationship between the pharmacokinetic parameters measured and the PFS at 24 months., Creation of predictive models using logistic models or PK-PD models with direct or indirect effects., Measurement of quality of life and correlation with observed toxicities.

Source: https://euclinicaltrials.eu/ctis-public/view/2024-513856-14-00